EU clinical trial 2025-520663-41-00: Jim Beam Cumulative Irritation Patch Test
Protocol code: 5004203
Sponsor: Reckitt Benckiser Healthcare (UK) Limited (Pharmaceutical company). Phase: Human Pharmacology (Phase I)- First administration to humans. Countries: Germany (ended).
Therapeutic area(s): Not possible to specify
Gender: Female, Male. Age: 18-64 years. Enrolment: 40.
Status: Ended. Start date (EU): 2025-07-21. End date (EU): 2025-08-14. Decision date: 2025-06-11. Results received: No. Last updated: 2025-06-11.

Condition(s): healthy volunteers

Source: https://euclinicaltrials.eu/ctis-public/view/2025-520663-41-00